EU clinical trial 2024-516443-57-00: HESTIA : A multicentric national phase II trial assessing TIslelizumab in monotherapy for patients with Hepatocellular Carcinoma Child-Pugh B and ALBI grade 1 or 2 liver function Score.
Protocol code: UC-GIG-2003
Sponsor: Unicancer (Hospital/Clinic/Other health care facility). Phase: Therapeutic exploratory (Phase II). Countries: France (ongoing, recruiting).
Therapeutic area(s): Diseases [C] - Neoplasms [C04]
Gender: Female, Male. Age: 18-64 years, 65+ years. Enrolment: 50.
Status: Ongoing, recruiting. Start date (EU): 2023-10-11. Decision date: 2024-08-27. Results received: No. Last updated: 2025-08-22.

Condition(s): Patients with Hepatocellular Carcinoma (HCC) and Child-Pugh B, ALBI grade 1 or 2 liver function, pretreated or not by tyrosine kinase inhibitors and not pretreated with immunotherapy.
Product: Tevimbra 100 mg concentrate for solution for infusion

Primary endpoint: The Objective Response Rate defined as the proportion of patients with Complete Response or Partial Response to treatment based on best overall response according to RECIST 1.1, recorded from treatment initiation to the end of treatment.
Endpoint(s): Frequency of limiting toxicity (LT), defined as any adverse event related to the experimental drug, and leading to definitive treatment discontinuation according to the investigator, before the second injection, Frequency of related and not related adverse events occurring during the treatment period and until 3 months after treatment discontinuation. Adverse events will be coded and categorized according MedDRA classification and CTCAE V5.0 grade for severity., Objective Response Rate defined as the proportion of patients with Complete Response or Partial Response to treatment based on best overall response according to mRECIST and iRECIST recorded from treatment initiation to the end of treatment., Overall survival, defined as the time between date of inclusion and death from any cause. Patients lost to follow-up will be censored at the date of last known to be alive., Progression-free survival, defined as the time between date of inclusion and disease progression or death, whichever occurs first. Disease progression will be evaluated 3 times according to RECIST v1.1, mRECIST and iRECIST, respectively. Patients lost to follow-up and patients who could benefit from secondary surgery for HCC will be censored at the date of last news and date of surgery, respectively., Time to progression is defined as the time between the date of inclusion and the date of radiological progression according RECIST v1.1. Death will be censored., Health Related Quality of Life according to EORTC QLQ-C30 and HCC-18

Source: https://euclinicaltrials.eu/ctis-public/view/2024-516443-57-00